EU clinical trial 2025-523714-92-00: Comparison of treatment efficacy in the patients with Systemic sclerOsis: dapagliFlozin vs. Tocilizumab – a randomized head to head study
Protocol code: 2025-ABM-CMKP-01
Sponsor: Centrum Medyczne Ksztalcenia Podyplomowego (Educational Institution). Phase: Therapeutic exploratory (Phase II). Countries: Poland (not authorised).
Therapeutic area(s): Diseases [C] - Musculoskeletal Diseases [C05]; Diseases [C] - Skin and Connective Tissue Diseases [C17]
Gender: Female, Male. Age: 18-64 years, 65+ years. Enrolment: 80.
Status: Not authorised. Decision date: 2025-12-15. Results received: No. Last updated: 2025-12-15.

Condition(s): Systemic Sclerosis
Product: NATRIUM CHLORATUM 0,9% FRESENIUS, 9 mg/ml, roztwór do infuzji, RoActemra 20 mg/mL concentrate for solution for infusion, RoActemra 20 mg/mL concentrate for solution for infusion, Forxiga 10 mg film-coated tablets, RoActemra 20 mg/mL concentrate for solution for infusion, Placebo dapagliflozyny

Primary endpoint: Change in disease severity in both arms assessed using the modified Rodnan Scale (mRSS) after 12 months of therapy. Non-inferiority assumption: the difference in improvement (reduction) between the study arms does not exceed 3 points.
Endpoint(s): Change in the systemic sclerosis severity score for dapagliflozin compared to tocilizumab after 12 months of therapy. Superiority assumption: the difference in improvement (reduction) between the study arms exceeds 3 points in favor of dapagliflozin., Results of capillaroscopic examination according to the Cutolo scale after 12 months of therapy., Results of cardiac functional and morphological parameters assessed by magnetic resonance imaging (MRI) and echocardiography after 12 months of therapy., Results of morphological parameters of lung aeration on high-resolution computed tomography (HRCT) of the chest after 12 months of therapy., Results of renal function parameters (eGFR, albuminuria) after 12 months of therapy., Results of proinflammatory cytokine concentrations after 12 months of therapy., Results of a questionnaire developed by prof. Wioletta Tuszyńska-Bogucka, PhD, and standardized tools: the SF-36 Questionnaire, Pol-SScQoL Questionnaire (a scale designed to assess the quality of life of SSc patients), the Stress Assessment Questionnaire (KOS) by Wrześniewski et al., the Goldberg General Health Questionnaire (GHQ) in the Polish adaptation by Makowska and Merecz, the PHQ-9 Depression Scale, and the GAD-7 (Generalized Anxiety Disorder 7-item Scale) after 12 months of therapy., Safety assessment of the therapies used will include an analysis of the occurrence and characteristics of adverse events and serious adverse events during the study.

Source: https://euclinicaltrials.eu/ctis-public/view/2025-523714-92-00